EU clinical trial 2024-510846-15-00: Efficacy, safety, and pharmacokinetics of NNC0519-0130 once weekly s.c. versus semaglutide 1.0 mg and placebo in people with chronic kidney disease, with or without type 2 diabetes, and with overweight or obesity: a proof-of-concept and dose-finding study
Protocol code: NN9541-7841
Sponsor: Novo Nordisk A/S (Pharmaceutical company). Phase: Therapeutic exploratory (Phase II). Countries: Poland (ongoing, recruitment ended), Bulgaria (ongoing, recruitment ended), Italy (ongoing, recruitment ended), Spain (ongoing, recruitment ended).
Therapeutic area(s): Not possible to specify; Diseases [C] - Nutritional and Metabolic Diseases [C18]
Gender: Female, Male. Age: 18-64 years, 65+ years. Enrolment: 120.
Status: Ongoing, recruitment ended. Start date (EU): 2025-04-14. Decision date: 2024-11-26. Results received: No. Last updated: 2026-06-30.
Decision dates by country: BG: 2024-12-02, IT: 2024-12-02, PL: 2024-12-02, ES: 2024-11-26

Condition(s): Chronic Kidney Disease, with or without Type 2 diabetes, Obesity
Product: Ozempic 0.5 mg solution for injection in pre-filled pen, Placebo A, NNC0519-0130

Primary endpoint: Change in UACR From baseline (week 0) to end of a given maintenance dose period (week 12, 24 or 36)
Endpoint(s): Change in eGFR (creatinine and cystatin C-based CKD-EPI 2021) from baseline to end of treatment, Change in eGFR (creatinine-based CKD-EPI 2021) from baseline to end of treatment, Relative change in body weight from baseline to end of treatment, Achievement of ≥ 5 % weight reduction from baseline to end of treatment, Achievement of ≥ 10 % weight reduction from baseline to end of treatment, Change in waist circumference from baseline to end of treatment, Change in glycated haemoglobin (HbA1c) from baseline to end of a given maintenance dose period (week 12, 24 or 36), Change in systolic blood pressure from baseline to end of treatment, Change in diastolic blood pressure from baseline to end of treatment, Number of treatment emergent adverse events (TEAEs) from baseline to end of study

Source: https://euclinicaltrials.eu/ctis-public/view/2024-510846-15-00